EU clinical trial 2025-522870-35-00: Upadacitinib in adult patients with erosive mucosal Lichen Planus and Lichen Planopilaris: a prospective multicenter randomized placebo-controlled study. (Upa30-LP)
Protocol code: 25-PP-10
Sponsor: Centre Hospitalier Universitaire De Nice (Hospital/Clinic/Other health care facility). Phase: Therapeutic exploratory (Phase II). Countries: France (authorised, recruitment pending).
Therapeutic area(s): Diseases [C] - Skin and Connective Tissue Diseases [C17]
Gender: Female, Male. Age: 18-64 years. Enrolment: 56.
Status: Authorised, recruitment pending. Decision date: 2026-03-09. Results received: No. Last updated: 2026-04-10.

Condition(s): Lichen
Product: Placebo is identifical in composition to rinovq but does not contain the substance medical, RINVOQ 30 mg prolonged-release tablets

Primary endpoint: Achievement of IGA response (absolute IGA score ≤2) at Week 16
Endpoint(s): Achievement of 2 points improvement in the IGA at Week 32, Achievement of DLQI 0/1 score at Week 16 and Week 32, PGIS at Week 16 and Week 32, PGIC at Week 16 and Week 32, Adverse events, laboratory values, vital signs from baseline to end of study visit analysis, Absolute and relative change in REU, OLPSSM and NRS score at Week 16 and Week 32, Absolute and relative change in LPPAI and SCALPDEX Questionnaire score at Week 16 and Week 32

Source: https://euclinicaltrials.eu/ctis-public/view/2025-522870-35-00